EU clinical trial 2025-522517-35-00: A Multicenter First-in-human Dose Escalation and Optimization Phase I/IIa Trial to Investigate Safety, Tolerability, Pharmacokinetics, and Efficacy of the 5T4 Antibody-Drug Conjugate TUB-030 in Patients with Advanced Solid Tumors (5-STAR 1-01)
Protocol code: 5-STAR 1-01
Sponsor: Tubulis GmbH (Pharmaceutical company). Phase: Phase I and Phase II (Integrated)- First administration to humans. Countries: France (authorised, recruitment pending), Spain (authorised, recruitment pending), Romania (ongoing, recruiting).
Therapeutic area(s): Diseases [C] - Neoplasms [C04]
Gender: Female, Male. Age: 18-64 years, 65+ years. Enrolment: 90.
Start date (EU): 2025-12-16. Decision date: 2025-11-03. Results received: No. Last updated: 2026-08-03.
Decision dates by country: FR: 2025-11-03, ES: 2025-11-05, RO: 2025-11-10

Condition(s): Patients with advanced/metastatic tumors with head and neck squamous cell carcinomas (HNSCC), non-small-cell lung cancer (NSCLC)
Product: TUB-030

Primary endpoint: (Dose escalation and backfill) Occurrence of dose-limiting toxicities (DLTs) at different dose levels (during first treatment cycle of 3 weeks), (Dose escalation and backfill) Occurrence and severity of treatment-emergent adverse events (TEAEs), (Dose Optimization) ORR, disease control rate (DCR) and DoR according to RECIST v1.1 assessed by INV at futility analysis and in addition by blinded independent central review (BICR) at final study analysis, (Dose Optimization) Occurrence of TEAEs and treatment-related AEs (TRAEs), (Dose Optimization) Incidence and severity of TEAEs and TRAEs
Endpoint(s): (Dose escalation and backfill) In addition to safety (TEAE) and tolerability, the pharmacokinetics (PK) profile and preliminary clinical activity will be considered to determine the dose for optimization, (Dose escalation and backfill) PK parameters of TUB-030, total mAb and free exatecan, including Cmax, Cmin, Tmax and as far as collected data allow an estimation of t1/2, and area under the curve (AUC), (Dose escalation and backfill) Incidence and semiquantitative titers of anti-drug antibodies (ADA) against TUB-030, (Dose escalation and backfill) Objective response rate (ORR) by RECIST v1.1 assessed by Investigator (INV), (Dose escalation and backfill) Disease control rate (DCR) assessed by INV, (Dose escalation and backfill) Duration of response (DoR) by RECIST v1.1 assessed by INV, (Dose escalation and backfill) Progression-free survival (PFS) by RECIST v1.1 assessed by INV, (Dose escalation and backfill) Incidence of serious adverse events (SAEs), (Dose escalation and backfill) Incidence of ≥grade 3 laboratory abnormalities, (Dose Optimization) PFS by RECIST v1.1 as assessed by INV at futility and at final study analysis and in addition retrospectively by BICR at final analysis, (Dose Optimization) OS by RECIST v1.1 as assessed by INV and retrospectively by BICR at final analysis, (Dose Optimization) Incidence of SAEs, (Dose Optimization) Incidence of ≥grade 3 laboratory abnormalities

Source: https://euclinicaltrials.eu/ctis-public/view/2025-522517-35-00